EU clinical trial 2023-506587-13-00: A Phase 2, Multicohort Open-Label Study of JNJ-68284528, a Chimeric Antigen Receptor T cell (CAR-T) Therapy Directed Against BCMA in Subjects with Multiple Myeloma CARTITUDE-2
Sponsor: Janssen - Cilag International (Pharmaceutical company). Phase: Therapeutic exploratory (Phase II). Countries: Spain (ongoing, recruitment ended), Netherlands (ongoing, recruitment ended), Germany (ongoing, recruitment ended), France (ended), Belgium (ongoing, recruitment ended).
Therapeutic area(s): Diseases [C] - Neoplasms [C04]
Gender: Female, Male. Age: 18-64 years, 65+ years. Enrolment: 56.
Start date (EU): 2020-01-30. Decision date: 2024-03-06. Results received: No. Last updated: 2025-09-02.
Decision dates by country: FR: 2024-03-06, NL: 2024-03-07, BE: 2024-03-26, ES: 2024-03-07, DE: 2024-03-15

Condition(s): Multiple Myeloma
Product: JNJ-54767414, Lenalidomide Accord 25 mg hard capsules, Lenalidomide Accord 5 mg hard capsules, Lenalidomide Accord 20 mg hard capsules, Dexamethasone Tablets BP 2.0mg, FLUDARABINE, Lenalidomide Accord 20 mg hard capsules, VELCADE 3.5 mg powder for solution for injection, Lenalidomide Accord 15 mg hard capsules, JNJ-68284528, Lenalidomide Accord 5 mg hard capsules, Lenalidomide Accord 25 mg hard capsules, Lenalidomide Accord 10 mg hard capsules, Dexamethason 4 mg JENAPHARM®, Lenalidomide Accord 15 mg hard capsules, Lenalidomide Accord 10 mg hard capsules, Endoxana Injection 1000 mg Powder for Solution for Injection

Primary endpoint: MRD negative rate (10-5 threshold) as defined by the International Myeloma Working Group (IMWG) criteria using next generation sequencing (NGS) or next generation flow (NGF)

Source: https://euclinicaltrials.eu/ctis-public/view/2023-506587-13-00